EU clinical trial 2024-516204-42-00: Selecting the optimal position of CDK4/6 inhibitors in HR+ advanced breast cancer: the SONIA trial
Protocol code: BOOG 2017-03
Sponsor: BOOG Study Center B.V. (Laboratory/Research/Testing facility). Phase: Therapeutic confirmatory (Phase III). Countries: Netherlands (ongoing, recruitment ended).
Therapeutic area(s): Diseases [C] - Neoplasms [C04]
Gender: Female. Age: 18-64 years, 65+ years. Enrolment: 1050.
Status: Ongoing, recruitment ended. Start date (EU): 2017-11-21. Decision date: 2024-11-12. Results received: No. Last updated: 2024-11-12.

Condition(s): Breast cancer
Product: Verzenios 100 mg film-coated tablets, IBRANCE 75 mg film-coated tablets, Kisqali 200 mg film-coated tablets, Kisqali 200 mg film-coated tablets, Kisqali 200 mg film-coated tablets, Kisqali 200 mg film-coated tablets, Verzenios 50 mg film-coated tablets, GOSERELIN, ESTRADIOL, Verzenios 150 mg film-coated tablets, ANASTROZOLE, Verzenios 50 mg film-coated tablets, FULVESTRANT, IBRANCE 100 mg film-coated tablets, Verzenios 100 mg film-coated tablets, Kisqali 200 mg film-coated tablets, LEUPRORELIN, Kisqali 200 mg film-coated tablets, Verzenios 150 mg film-coated tablets, IBRANCE 125 mg film-coated tablets, LETROZOLE

Primary endpoint: Progression-free survival after two lines of treatment (PFS2) defined as time from randomization until one of the following (whichever occurs first): second objective disease progression or objective disease progression on second-line therapy, whichever occurs first, symptomatic deterioration on second-line therapy leading to discontinuation of second-line therapy initiation of chemotherapy for breast cancer or death
Endpoint(s): Overall survival, Quality of life, Safety and tolerability, Objective response rate (ORR), Cost-effectiveness, Type and incidence of grade 3 and 4 (serious) adverse events ((S)AE) (as graded by NCI CTCAE v4.0) and its relation to study medications., Tumor tissue biomarkers, including genes, proteins and (mi)RNA expression, Circulating tumor DNA (ctDNA) in plasma, Nuclear imaging, including FDG-PET and FES-PET, Pharmacokinetics, -dynamics and -genomics of CDK4/6 inhibitors, Cognitive functioning as assessed by validated online cognitive tests

Source: https://euclinicaltrials.eu/ctis-public/view/2024-516204-42-00